EU clinical trial 2023-507236-20-00: A Phase Ib/II, Open-Label, Multicenter Study with a Non-Randomized Stage Evaluating the Safety, Pharmacokinetics, and Efficacy of Mosunetuzumab Plus Lenalidomide (+LEN), and a Randomized Stage Evaluating the Safety, Tolerability, and Pharmacokinetics of SC Versus IV Mosunetuzumab+LEN in Patients with Follicular Lymphoma
Protocol code: CO41942
Sponsor: F. Hoffmann-La Roche AG (Pharmaceutical company). Phase: Phase I and Phase II (Integrated)- Other. Countries: Spain (ongoing, recruitment ended), France (ongoing, recruitment ended).
Therapeutic area(s): Diseases [C] - Neoplasms [C04]
Gender: Female, Male. Age: 18-64 years, 65+ years. Enrolment: 117.
Status: Ongoing, recruitment ended. Start date (EU): 2020-07-28. Decision date: 2024-05-14. Results received: No. Last updated: 2026-07-31.
Decision dates by country: ES: 2024-05-14, FR: 2024-05-17

Condition(s): Follicular Lymphoma (FL)
Product: Mosunetuzumab, Mosunetuzumab, Mosunetuzumab, Revlimid 5 mg hard capsules, RoActemra 20 mg/mL concentrate for solution for infusion, Mosunetuzumab, Mosunetuzumab, Revlimid 10 mg hard capsules

Primary endpoint: 1. Non-randomized Stage: Dose-limiting toxicity, 2. Non-randomized Stage: Incidence, nature, and severity of physical findings and adverse events, with severity determined according to the National Cancer Institute Common Terminology Criteria for Adverse Events version 5 (NCI CTCAE v5.0); for CRS, severity determined according to the American Society for Transplantation and Cellular Therapy (ASTCT) cytokine-release syndrome (CRS) grading criteria, 3. Non-randomized Stage : Change from baseline in targeted vital signs, 4. Non-randomized Stage : Change from baseline in targeted clinical laboratory test results, 5. Non-randomized Stage : Tolerability, as assessed by the incidence of dose interruptions, dose reductions and dose intensity, and treatment discontinuation not due to efficacy events, 6. ORR, defined as the proportion of patients whose best overall response is a PR or a CR during the study., 7. Randomized stage: Cumulative Area under the concentration-time curve (AUC) over Cycles 1-3 (AUCC1-3), 8. Randomized stage: Serum trough concentration at steady state, approximated by Cycle 4 (Ctrough, C4)
Endpoint(s): 1. Non-randomized and Randomized stages : Complete response rate, 2. Non-randomized and Randomized stages : Objective response rate, 3. Non-randomized and Randomized stages : Duration of response, 4. Non-randomized and Randomized stages : Duration of complete response, 5. Non-randomized Stage : Minimum serum concentration (Cmin) of Mosun+ Len, 6. Non-randomized Stage : Maximum serum concentration (Cmax) of Mosun+ Len, 7. Randomized stage: Area under the concentration-time curve (AUC) of Mosun+ Len, 8. Non-randomized and Randomized stages: Prevalence of anti-drug antibodies (ADAs) at baseline and incidence of ADAs during the study, 9. Randomized stage: Incidence, nature, and severity of physical findings and adverse events, with severity determined according to the National Cancer Institute Common Terminology Criteria for Adverse Events version 5 (NCI CTCAE v5.0); for CRS, severity determined according to the ASTCT CRS grading criteria, 10. Randomized stage: Change from baseline in targeted vital signs, 11. Randomized stage: Change from baseline in targeted clinical laboratory test results, 12. Randomized stage: Tolerability, as assessed by the incidence of dose interruptions, dose reductions and dose intensity, and treatment discontinuation not due to efficacy events, 13. Randomized stage: Cumulative AUC over Cycles 1-2 (AUCC1-2), 14. Randomized stage: Serum trough concentration in Cycle 2 (Ctrough, C2), 15. Randomized stage: AUC at steady state (AUCss)

Source: https://euclinicaltrials.eu/ctis-public/view/2023-507236-20-00